EU clinical trial 2024-511561-10-00: A Phase II Multi-Arm (basket) Trial Investigating the Safety and Efficacy of IO102-IO103 in Combination with Pembrolizumab, as First-line Treatment for Patients with Metastatic Non-Small Cell Lung Cancer (NSCLC), Squamous Cell Carcinoma of Head and Neck (SCCHN), or Metastatic Urothelial Bladder Cancer (mUBC)
Protocol code: IOB-022/KN-D38
Sponsor: Io Biotech ApS (Pharmaceutical company). Phase: Therapeutic exploratory (Phase II). Countries: Spain (ended).
Therapeutic area(s): Diseases [C] - Neoplasms [C04]
Gender: Female, Male. Age: 18-64 years, 65+ years. Enrolment: 38.
Status: Ended. Start date (EU): 2022-05-31. End date (EU): 2025-11-28. End date: 2025-11-29. Decision date: 2024-02-12. Results received: No. Last updated: 2025-05-14.

Condition(s): Metastatic Squamous Cell Carcinoma of Head and Neck (SCCHN), Metastatic Urothelial Bladder Cancer (mUBC), Metastatic Non-Small Cell Lung Cancer (NSCLC)
Product: IO102-IO103, KEYTRUDA 25 mg/mL concentrate for solution for infusion

Primary endpoint: Overall objective response rate (ORR) according to RECIST v. 1.1
Endpoint(s): Progression-Free Survival (PFS) according to RECIST v. 1.1, Duration of response (DOR), Complete response rate (CRR), Disease control rate (DCR), Time to response (TTR), Safety

Source: https://euclinicaltrials.eu/ctis-public/view/2024-511561-10-00